EU clinical trial 2024-511961-12-00: Adaptative, multicenter, randomized, double-blind, parallel-group, placebo controlled, clinical trial, on the efficacy and tolerability of different escalating doses of intra-articular clodronate in patients with painful knee osteoarthritis
Protocol code: SPA-S-899-01-21
Sponsor: Spa Societa Prodotti Antibiotici S.p.A. (Pharmaceutical company). Phase: Phase II and Phase III (Integrated). Countries: Italy (ongoing, recruiting).
Therapeutic area(s): Diseases [C] - Musculoskeletal Diseases [C05]
Gender: Female, Male. Age: 18-64 years, 65+ years. Enrolment: 278.
Status: Ongoing, recruiting. Start date (EU): 2023-10-12. Decision date: 2024-08-13. Results received: No. Last updated: 2026-04-29.

Condition(s): Knee osteoarthritis
Product: disodium clodronate, disodium clodronate, The Placebo composition is identical to the IMP, except for the active substance., disodium clodronate

Primary endpoint: A clodronate dose will be considered as effective when a ≥ 8.5 mm reduction in the VAS of knee pain will be observed at Week 7 vs. Placebo.
Endpoint(s): Mean changes in the VAS of knee pain observed at each other visit than Week 7 vs. Placebo and vs Baseline., Mean changes in the VAS of knee pain observed 120 minutes after IA injection at Baseline, Weeks 1, 2 and 3 vs predose assessment., Mean changes in the Lequesne Algo-functional Index at each visit vs Placebo and vs Baseline., Mean changes in the WOMAC Index at each visit vs Placebo and vs Baseline., Mean changes in the Range of Motion at each visit vs Placebo and vs Baseline., Use of rescue drug consumption (paracetamol) across the patients visits.

Source: https://euclinicaltrials.eu/ctis-public/view/2024-511961-12-00